EU clinical trial 2024-515588-67-00: Identification and clinical relevance of an oxytocin-deficient state: randomized, crossover, placebo-controlled pilot physiopathological study: GLP1 Study.
Sponsor: Fundacio Institut De Recerca De L'Hospital De La Santa Creu I Sant Pau (Hospital/Clinic/Other health care facility). Phase: Phase I and Phase II (Integrated)- Other. Countries: Spain (ended).
Therapeutic area(s): Phenomena and Processes [G] - Metabolism [G03]
Gender: Female, Male. Age: 18-64 years. Enrolment: 52.
Status: Ended. Start date (EU): 2021-06-10. End date (EU): 2024-08-02. Decision date: 2024-06-26. Results received: No. Last updated: 2024-06-26.

Condition(s): Hypopituarism
Product: Byetta 10 micrograms solution for injection in pre-filled pen

Primary endpoint: Pattern of OT hormone secretion after administration of the study agent (GLP1 vs. placebo).
Endpoint(s): Secondary variables will be those related to the results of validated questionnaires for the assessment of mood, alexithymia, impulsivity, quality of life, eating behavior and sexual function and their associations with OT secretion parameters.

Source: https://euclinicaltrials.eu/ctis-public/view/2024-515588-67-00